EU clinical trial 2026-526311-11-00: An Open-label Phase 1 Study in Healthy Adult Participants to Investigate the Effect of Itraconazole on the Blood Levels of Engasertib
Protocol code: ENG-101
Sponsor: Vaderis Therapeutics AG (Pharmaceutical company). Phase: Human Pharmacology (Phase I)- Other. Countries: Germany (authorised, recruitment pending).
Therapeutic area(s): Diseases [C] - Congenital, Hereditary, and Neonatal Diseases and Abnormalities [C16]
Gender: Female, Male. Age: 18-64 years. Enrolment: 27.
Status: Authorised, recruitment pending. Decision date: 2026-07-29. Results received: No. Last updated: 2026-07-29.

Condition(s): This clinical trial is performed in healthy participants; the planned indication: Treatment of Hereditary hemorrhagic telangiectasia (HHT)

Source: https://euclinicaltrials.eu/ctis-public/view/2026-526311-11-00